EU clinical trial 2024-520315-40-00: A Single-Dose Pharmacokinetic Study of Lepodisiran in Participants with Varying Degrees of Liver Impairment and Participants with Normal Liver Function
Protocol code: J3L-MC-EZEH
Sponsor: Eli Lilly & Co. (Pharmaceutical company). Phase: Human Pharmacology (Phase I)- Other. Countries: Hungary (ended).
Therapeutic area(s): Diseases [C] - Digestive System Diseases [C06]
Gender: Female, Male. Age: 18-64 years, 65+ years. Enrolment: 6.
Status: Ended. Start date (EU): 2025-07-22. End date (EU): 2026-07-16. End date: 2026-07-17. Decision date: 2025-06-16. Results received: No. Last updated: 2026-07-06.

Condition(s): Normal Hepatic Function and Mild, Moderate, or Severe Hepatic Impairment

Source: https://euclinicaltrials.eu/ctis-public/view/2024-520315-40-00